EU clinical trial 2024-511141-19-00: Use of Imatinib to convert triple negative breast cancer into ER-positive breast cancer: I-CONIC
Sponsor: Vaestra Goetalandsregionen (Hospital/Clinic/Other health care facility). Phase: Therapeutic exploratory (Phase II). Countries: Sweden (ongoing, recruiting).
Therapeutic area(s): Diseases [C] - Neoplasms [C04]
Gender: Female, Male. Age: 18-64 years, 65+ years. Enrolment: 40.
Status: Ongoing, recruiting. Start date (EU): 2022-08-22. Decision date: 2024-10-08. Results received: No. Last updated: 2024-10-08.

Condition(s): Primary breast cancer
Product: IMATINIB

Primary endpoint: Immunohistochemistry fraction of Estrogen Receptor is changed from 0% to 2% or more after imatinib treatment, Immunohistochemistry fraction of Estrogen Receptor is changed from 1-9% to ≥10% after imatinib treatment, Immunohistochemistry fraction of Estrogen Receptor 1-9% increase with at least 2%, coupled with a significant increase luminal gene transcripts
Endpoint(s): Safety analyses according to common terminology criteria for adverse events (CTCAE) v.5: up to 30 days after the last dose of imatinib., Identification of predictive markers for conversion by evaluation of molecular characteristics (gene expression profiles, intrinsic subtypes and proliferation) and immune response in tissue and blood before start of imatinib and in the surgical specimen.

Source: https://euclinicaltrials.eu/ctis-public/view/2024-511141-19-00